EU clinical trial 2026-525333-22-00: SAR447971 first-in-human study
Protocol code: SAD20411-MAD20412
Sponsor: Sanofi-Aventis Recherche & Developpement (Pharmaceutical company). Phase: Human Pharmacology (Phase I)- First administration to humans. Countries: Netherlands (ongoing, recruiting).
Therapeutic area(s): Diseases [C] - Immune System Diseases [C20]
Gender: Female, Male. Age: 18-64 years. Enrolment: 134.
Status: Ongoing, recruiting. Start date (EU): 2026-05-22. Decision date: 2026-05-20. Results received: No. Last updated: 2026-06-25.

Condition(s): Hidradenitis

Source: https://euclinicaltrials.eu/ctis-public/view/2026-525333-22-00